EU clinical trial 2024-512066-33-00: A 12-month, interventional, open-label, phase 4 study in Europe (SHINE) to investigate the course of synovial hypertrophy as detected by joint ultrasound and MRI in patients with haemophilia A on efanesoctocog alfa prophylaxis.
Protocol code: Sobi.BIVV001-004
Sponsor: Swedish Orphan Biovitrum AB (publ) (Pharmaceutical company). Phase: Therapeutic use (Phase IV). Countries: Sweden (ongoing, recruitment ended), Italy (ongoing, recruitment ended), Norway (ongoing, recruitment ended), Spain (ongoing, recruitment ended).
Therapeutic area(s): Diseases [C] - Congenital, Hereditary, and Neonatal Diseases and Abnormalities [C16]
Gender: Female, Male. Age: 0-17 years, 18-64 years, 65+ years. Enrolment: 50.
Status: Ongoing, recruitment ended. Start date (EU): 2024-12-19. Decision date: 2024-11-18. Results received: No. Last updated: 2026-06-25.
Decision dates by country: IT: 2024-11-21, NO: 2024-11-21, SE: 2024-11-18, ES: 2024-12-20

Condition(s): Haemophilia A
Product: ALTUVOCT 2 000 IU powder and solvent for solution for injection, ALTUVOCT 250 IU powder and solvent for solution for injection, ALTUVOCT 500 IU powder and solvent for solution for injection, ALTUVOCT 4 000 IU powder and solvent for solution for injection, ALTUVOCT 3 000 IU powder and solvent for solution for injection

Primary endpoint: Joints with synovial hypertrophy at baseline (HEAD-US synovial hypertrophy domain score of 1 or 2) and at least 1 point decrease in HEAD-US synovial hypertrophy domain score at Month 12 (Yes/No)
Endpoint(s): Joints with no synovial hypertrophy at baseline (HEAD-US synovial hypertrophy domain score 0) and at least 1 point increase in HEAD-US synovial hypertrophy domain score at Month 6 or Month 12 (Yes/No), Distribution of joint HEAD-US synovial hypertrophy domain scores 0/1/2 at baseline and at Months 6 and 12, Change from baseline in total/domain scores of HEAD-US per patient and per joint at Months 6 and 12, Change from baseline in total/domain scores of International Prophylaxis Study Group (IPSG) MRI per patient and per joint at Month 12, Change from baseline in total/domain scores of HJHS per patient and per joint at Month 12, Patients with improved, unchanged, or worsened total/domain HEAD-US/MRI/HJHS scores at Month 12 from baseline, Changes in PROs from baseline to Month 6 and Month 12 (assessed by 5- level EuroQol-5 dimensions [EQ-5D-5L], Patient-Reported Outcomes Measurement Information System [PROMIS] pain intensity, PROMIS pain interference, and PROMIS physical function), Patient-reported treatment preference at Month 12 (assessed with a questionnaire and exit interview), Change in ABR and annualized joint bleeding rate (AjBR) (spontaneous, traumatic) based on treated bleeds from the retrospective data collection period to on-study period, Patients with target joint resolution or development from baseline to Month 12, The occurrence of treatment-emergent adverse events (TEAEs) leading to treatment discontinuation, serious TEAEs, and adverse events of special interest (AESIs)

Source: https://euclinicaltrials.eu/ctis-public/view/2024-512066-33-00